EU clinical trial 2022-502966-26-01: A randomized, double-blind 2-arm, followed by an open-label 1-arm, NEPTUNUS extension study to assess the long-term safety and efficacy of ianalumab in patients with Sjögren’s syndrome
Protocol code: CVAY736A2301E1
Sponsor: Novartis Pharma AG (Pharmaceutical company). Phase: Therapeutic confirmatory (Phase III). Countries: Greece (ongoing, recruitment ended), France (ongoing, recruitment ended), Poland (ongoing, recruitment ended), Bulgaria (ongoing, recruitment ended), Germany (ongoing, recruitment ended), Austria (ongoing, recruitment ended), Portugal (ongoing, recruitment ended), Slovakia (ongoing, recruitment ended), Hungary (ongoing, recruitment ended), Czechia (ongoing, recruitment ended), Spain (ongoing, recruitment ended), Sweden (ended), Romania (ongoing, recruitment ended), Italy (ongoing, recruitment ended), Lithuania (ongoing, recruitment ended), Belgium (ongoing, recruitment ended).
Therapeutic area(s): Diseases [C] - Immune System Diseases [C20]
Gender: Female, Male. Age: 18-64 years, 65+ years. Enrolment: 278.
Start date (EU): 2023-10-27. Decision date: 2023-10-09. Results received: No. Last updated: 2026-07-31.
Decision dates by country: SE: 2023-12-18, AT: 2023-10-16, IT: 2023-12-13, HU: 2023-10-11, DE: 2023-10-12, PL: 2023-10-16, RO: 2023-12-18, PT: 2023-10-10, GR: 2023-10-09, CZ: 2023-10-12, BE: 2024-05-21, SK: 2023-10-09, BG: 2023-10-16, ES: 2023-10-10, FR: 2023-10-10, LT: 2024-01-22

Condition(s): Sjögren’s syndrome
Product: Placebo to VAY736 300 mg/2 mL Solution for injection in pre-filled pen, Placebo to VAY736 300 mg/2 mL Solution for injection in pre-filled syringe, VAY736, VAY736, ENTECAVIR, LAMIVUDINE, TENOFOVIR DISOPROXIL, TENOFOVIR ALAFENAMIDE

Primary endpoint: Incidence of treatment-emergent AEs (TEAEs)/SAEs
Endpoint(s): ESSDAI change from baseline, Achieving ≥2.3 points reduction from baseline in ESSPRI among participants with baseline ESSPRI ≥3 score over time, Achieving ≥2.0 points reduction from baseline in SSSD among participants with baseline SSSD ≥3 over time up to Week 360, Ianalumab serum concentrations collected pre-dose (i.e., Ctrough) at Week 48 (from core studies) and Week 64, Ianalumab serum concentrations during treatment (e.g., Ctrough) and follow-up after last dose, B-cell count measurement, Achieving ≥ 5 points reduction from baseline in ESSDAI, SSSD change from baseline, ESSPRI change from baseline

Source: https://euclinicaltrials.eu/ctis-public/view/2022-502966-26-01